EU clinical trial 2025-522592-29-00: Effect of Romosozumab vs. Denosumab on Coronary Atherosclerotic Damage in Postmenopausal Osteoporotic Women: A Phase IV, Low-Risk, Pharmacological Intervention Study. ATRIO Study.
Protocol code: ATRIO (L4204)
Sponsor: Ospedale Galeazzi S.p.A. (Hospital/Clinic/Other health care facility). Phase: Therapeutic use (Phase IV). Countries: Italy (authorised, recruitment pending).
Therapeutic area(s): Diseases [C] - Musculoskeletal Diseases [C05]
Gender: Female. Age: 18-64 years, 65+ years. Enrolment: 60.
Status: Authorised, recruitment pending. Decision date: 2026-02-23. Results received: No. Last updated: 2026-08-07.

Condition(s): Coronary atherosclerotic status in women with postmenopausal osteoporosis
Product: EVENITY 105 mg solution for injection in pre-filled pen, EVENITY 105 mg solution for injection in pre-filled pen, Prolia 60 mg solution for injection in pre-filled syringe, EVENITY 105 mg solution for injection in pre-filled pen, Prolia 60 mg solution for injection in pre-filled syringe, EVENITY 105 mg solution for injection in pre-filled pen, Prolia 60 mg solution for injection in pre-filled syringe, Prolia 60 mg solution for injection in pre-filled syringe, EVENITY 105 mg solution for injection in pre-filled pen, Prolia 60 mg solution for injection in pre-filled syringe, Prolia 60 mg solution for injection in pre-filled syringe, Prolia 60 mg solution for injection in pre-filled syringe, Prolia 60 mg solution for injection in pre-filled syringe, EVENITY 105 mg solution for injection in pre-filled pen, EVENITY 105 mg solution for injection in pre-filled pen, Prolia 60 mg solution for injection in pre-filled syringe, EVENITY 105 mg solution for injection in pre-filled pen

Primary endpoint: Difference in coronary CT score according to the CCTA-Leaman method after 12 months of therapy (at V3 compared V1) with Romosozumab and Denosumab.
Endpoint(s): Change in scores: Segment Involvement Score (SIS) and Segment Stenosis Score (SSS) between V1 and V3, Measurement of biomarkers at V1 and their correlation with changes in coronary scores: Sclerostin, Lipoprotein-Associated Phospholipase A2, Myeloid-Related Protein 8 and 14, and Monocyte Chemoattractant Protein 1 (MCP-1)., Difference between CCTA-Leaman SIS, SSS between the two groups at V3

Source: https://euclinicaltrials.eu/ctis-public/view/2025-522592-29-00